EU clinical trial 2023-507972-35-01: Clinical Evaluation of Metal Panel Allergens: Safety and Efficacy Study
Sponsor: Smarthealth Inc. (Pharmaceutical company). Phase: Therapeutic confirmatory (Phase III). Countries: Germany (ongoing, recruiting), Netherlands (ongoing, recruiting), Italy (ongoing, recruiting).
Therapeutic area(s): Diseases [C] - Skin and Connective Tissue Diseases [C17]
Gender: Female, Male. Age: 18-64 years, 65+ years. Enrolment: 95.
Status: Ongoing, recruiting. Start date (EU): 2025-03-24. Decision date: 2024-06-25. Results received: No. Last updated: 2025-06-16.
Decision dates by country: DE: 2024-06-25, NL: 2024-06-26, IT: 2024-06-27

Condition(s): Allergic contact dermatitis
Product: Copper Allergen (copper sulfate pentahydrate 2%), Tin Allergen (stannous chloride 1%), Sodium Allergen (sodium tetrachloropalladate 3%), Manganese Allergen (manganese chloride tetrahydrate 2%), Kaliumdichromat 0,5%, Testsalbe, Ammonium Allergen (ammonium titanium oxide oxalate 21%), Nickel(II)-sulfat, 6*H2O 5%, Testsalbe, Zinc Allergen (zinc chloride 1%), Kobaltchlorid 1%, Testsalbe, Vanadium Allergen (vanadium oxide sulfate 1.3%), Metal Panel Allergens, Gold Allergen (gold sodium thiosulfate (GST) 2.0%)

Primary endpoint: Concordance (agreement) between the hydrogel (investigational allergen) and petrolatum (reference allergen) patch testing methods using Cohen’s kappa calculation and by positive and negative percent agreement.
Endpoint(s): Measures of allergen safety and performance of device constituent.

Source: https://euclinicaltrials.eu/ctis-public/view/2023-507972-35-01